EU clinical trial 2024-514087-11-02: A phase-2 clinical trial of regorafenib in patients with pretreated advanced melanoma
Sponsor: UZ Brussel (Hospital/Clinic/Other health care facility). Phase: Therapeutic exploratory (Phase II). Countries: Belgium (ongoing, recruiting).
Therapeutic area(s): Diseases [C] - Skin and Connective Tissue Diseases [C17]
Gender: Female, Male. Age: 18-64 years, 65+ years. Enrolment: 87.
Status: Ongoing, recruiting. Start date (EU): 2022-10-03. Decision date: 2024-09-20. Results received: No. Last updated: 2025-03-17.

Condition(s): Melanoma
Product: Stivarga 40 mg film-coated tablets

Primary endpoint: Objective response rate (ORR; defined as the percentage of subjects with a confirmed complete response [CR] or partial response [PR] at any time per Response Evaluation Criteria in Solid Tumors [RECIST], version 1.1, [4])
Endpoint(s): Disease control rate (DCR; defined as the percentage of subjects with a confirmed stable disease (SD), partial response (PR) or complete response (CR) at any time per Response Evaluation Criteria in Solid Tumors (RECIST), version 1.1. [4]), Objective response rate (ORR; defined as the percentage of subjects with a confirmed complete response [CR] or partial response [PR] at any time per Response Evaluation Criteria in Solid Tumors [RECIST], version 1.1, [4] and RANO-BM criteria [5]) determined separately for extra- and intracranial metastases, respectively., Progression-free survival (PFS; defined as the time from the date of the first dose of regorafenib until the earliest date of documented disease progression [per RECIST v1.1] or death due to any cause) and overall survival (OS; defined as the time from the date of the first dose of regorafenib until the date of death due to any cause)., Safety as assessed by anamnesis, clinical examination, analysis of blood and urine, electrocardiograms, cardiac echocardiography, and any additional medical examination that is indicated. AE will be graded by the Common Terminology Criteria of Adverse events (CTCAE), version 5.0 (National Institutes of Health, National Cancer Institute)., Duration of response (DOR; defined as the time from the date of first documented response (SD, PR or CR) until the earliest date of documented disease progression., • The generic health status of the patients will be assessed by means of the EuroQOL-5D-3L (EQ-5D-3L). • Health-related quality of life (HRQoL) will be assessed with the European Organization for Research and Treatment of Cancer quality of life questionnaire-C30 (EORTC-QLQ-C30). • Melanoma specific health-related quality of life will be evaluated with the Functional Assessment of Cancer Therapy-Melanoma questionnaire (FACT-M)

Source: https://euclinicaltrials.eu/ctis-public/view/2024-514087-11-02